EU clinical trial 2024-517537-40-00: Treating Nightmares in Posttraumatic Stress Disorder with the α-adrenergic Agents Clonidine and Doxazosin: A Randomized-Controlled Feasibility Study - ClonDoTrial
Protocol code: ClonDO
Sponsor: Charite Universitaetsmedizin Berlin KöR (Hospital/Clinic/Other health care facility). Phase: Therapeutic exploratory (Phase II). Countries: Germany (ended).
Therapeutic area(s): Psychiatry and Psychology [F] - Mental Disorders [F03]
Gender: Female, Male. Age: 18-64 years. Enrolment: 189.
Status: Ended. Start date (EU): 2022-04-06. End date (EU): 2025-08-08. Decision date: 2024-10-23. Results received: No. Last updated: 2024-10-23.

Condition(s): Posttraumatic Stress Disorder
Product: Placebo 2: week 1-11; capsules size 1, color swedish-orange (320 mg kapselfüllstoff mannitol (typ 60) 99,5% & siliciumdioxid, hochdispers 0,5%) oder 273 mg standardisierten kapselfüllstoff nach nrf s.38.), Doxacor® 2 mg, Clonidin-ratiopharm® 75 75 Mikrogramm Tabletten, Doxazosin STADA® 1 mg Tabletten, Placebo 1: week 1, Capsules DB B, color swedish-orange (320 mg Kapselfüllstoff Mannitol (Typ 60) 99,5% & Siliciumdioxid, hochdispers 0,5% oder 247mg standardisierten Kapselfüllstoff nach NRF S.38.)

Primary endpoint: Primary efficacy endpoint: Change of Frequency and intensity of nightmares, measured with the Clinician-Administered PTSD Scale-IV (CAPS-IV) B2 score for the last week, range 0–8, from baseline until directly after last intervention (10 weeks, visit 9). A lower score indicates less frequent and/or intense nightmares.
Endpoint(s): Change from baseline of the frequency and intensity of nightmares, measured with the Clinician-Administered PTSD Scale-IV (CAPS-IV) B2 score for the last week, range 0–8, at Visit 2 – Visit 8, Change from baseline of the CAPS-5 total score (overall PTSD symptoms, last week) at Visit 7 and Visit 9, Change from baseline of the Pittsburgh Sleep Quality Index- Addendum for PTSD (PSQI A) (PTSD related sleep symptoms) at Visit 7 and Visit 9, Change from baseline of the Montgomery Asberg Depression Inventory (MADRS) at Visit 7 and Visit 9, Weekly mean of change from baseline of the patients daily total sleep time (in minutes), sleep onset latency at night (in minutes), recuperation of night sleep (5-point Likert scale, 1 = very much; 5 = not at all), and time awake at night (in minutes), number of nightmares last night (0, 1, 3, 4 or more) and intensity of nightmares (5-point Likert scale, 0 = not at all; 5 = extreme) assessed with sleep diaries during Visit 2 – Visit 9, Change from baseline of PTSD symptoms assessed with the PTSD Checklist for DSM-5 (PCL-5) at Visit 7 and Visit 9, Change from baseline of the Borderline Symptom List 23 (BSL-23) score at Visit 7 and Visit 9, Change from baseline of the Health-Related Quality of Life (EQ-5D) score at Visit 7 and Visit 9, Overall patient status measured by the Patient Global Impression of Change (PGIC) at Visit 7 and Visit 9, Change from baseline of the Social and Occupational Functioning Assessment Scale (SOFAS) at Visit 7 and Visit 9, Change from baseline of the Pittsburgh Sleep Quality Index (PSQI) at Visit 7 and Visit 9, Change from baseline of symptoms of PTSD and complex PTSD according to ICD-11 assessed with the International Trauma Questionnaire (ITQ) at Visit 7 and Visit 9, Responder analysis: proportion of patients showing improvement in nightmares (change from baseline) defined as decrease of CAPS-IV B2 ≥ 50% assessed at the end of treatment (Visit 9), Remitter analysis: proportion of patients showing full remission of nightmares defined as CAPS-IV B2 = 0, assessed at the end of treatment (Visit 9)

Source: https://euclinicaltrials.eu/ctis-public/view/2024-517537-40-00